EU clinical trial 2023-509560-16-00: A Phase 3, Multicenter, Open-label, Basket, Long-term Extension Study to Evaluate the Safety of Guselkumab in Pediatric Participants with Crohn’s Disease, Ulcerative Colitis, or Juvenile Psoriatic Arthritis
Protocol code: CNTO1959ISD3001
Sponsor: Janssen Cilag International (Pharmaceutical company). Phase: Therapeutic confirmatory (Phase III). Countries: Spain (ongoing, recruiting), Germany (ongoing, recruiting), Poland (ongoing, recruiting), Italy (ongoing, recruiting), Norway (ongoing, recruiting), France (ongoing, recruiting), Portugal (ongoing, recruiting), Belgium (authorised, recruitment pending).
Therapeutic area(s): Diseases [C] - Skin and Connective Tissue Diseases [C17]; Diseases [C] - Digestive System Diseases [C06]; Diseases [C] - Immune System Diseases [C20]
Gender: Female, Male. Age: 0-17 years, 18-64 years. Enrolment: 85.
Start date (EU): 2024-10-29. Decision date: 2024-07-05. Results received: No. Last updated: 2026-07-29.
Decision dates by country: IT: 2025-02-11, DE: 2025-01-28, PL: 2025-03-10, PT: 2025-09-16, FR: 2025-10-17, ES: 2024-07-05, NO: 2025-04-25, BE: 2026-04-07

Condition(s): Juvenile psoriatic arthritis (jPsA), Moderately to severely active ulcerative colitis (UC), Moderately to severely active Crohn's disease (CD)
Product: Guselkumab - solution for injection in pre-filled syringe - 100 mg/mL, Guselkumab, Guselkumab

Primary endpoint: No primary or secondary endpoints will be collected in this study.

Source: https://euclinicaltrials.eu/ctis-public/view/2023-509560-16-00